EU clinical trial 2024-514448-10-00: Bioequivalence of Nilotinib 200 mg Capsules in Healthy Participants Under Fasting Conditions.
Protocol code: BLCL-NIL-FDA-02
Sponsor: Bluepharma Industria Farmaceutica S.A. (Pharmaceutical company). Phase: Human Pharmacology (Phase I)- Bioequivalence Study. Countries: Portugal (ended).
Therapeutic area(s): Not possible to specify
Gender: Female, Male. Age: 18-64 years. Enrolment: 88.
Status: Ended. Start date (EU): 2024-08-09. End date (EU): 2024-09-27. Decision date: 2024-07-12. Results received: No. Last updated: 2024-07-12.

Condition(s): No medical condition.

Source: https://euclinicaltrials.eu/ctis-public/view/2024-514448-10-00